EU clinical trial 2023-506888-34-00: A Phase 1a/1b Study Investigating the Safety, Tolerability, Pharmacokinetics, Pharmacodynamics, and Preliminary Antitumor Activity of the CDK4 Inhibitor BGB-43395, Alone or as Part of Combination Therapies in Patients With Metastatic HR+/HER2- Breast Cancer and Other Advanced Solid Tumors
Protocol code: BGB-43395-101
Sponsor: BeOne Medicines AG (Pharmaceutical company). Phase: Human Pharmacology (Phase I)- First administration to humans. Countries: France (ongoing, recruiting).
Therapeutic area(s): Diseases [C] - Neoplasms [C04]
Gender: Female, Male. Age: 18-64 years, 65+ years. Enrolment: 91.
Status: Ongoing, recruiting. Start date (EU): 2024-05-22. Decision date: 2024-02-26. Results received: No. Last updated: 2026-06-01.

Condition(s): Advanced or metastatic solid tumors including hormone receptor positive (HR+), human epidermal growth factor 2 negative (HER2-) breast cancer

Source: https://euclinicaltrials.eu/ctis-public/view/2023-506888-34-00